EU clinical trial 2025-524487-37-00: Real-World Effectiveness and Safety of Pegcetacoplan in Patients with C3 Glomerulopathy (C3G) or Primary Immune Complex Membranoproliferative Glomerulonephritis (IC-MPGN): A Multi-Country Study (PRISMC3)
Protocol code: Sobi.PEGCET-402
Sponsor: Swedish Orphan Biovitrum AB (publ) (Pharmaceutical company). Phase: Therapeutic use (Phase IV). Countries: France (authorised, recruitment pending), Italy (authorised, recruitment pending), Spain (authorised, recruiting), Germany (ongoing, recruiting).
Therapeutic area(s): Diseases [C] - Immune System Diseases [C20]
Gender: Female, Male. Age: 0-17 years, 18-64 years, 65+ years. Enrolment: 69.
Start date (EU): 2026-07-09. Decision date: 2026-06-15. Results received: No. Last updated: 2026-06-17.
Decision dates by country: FR: 2026-06-17, DE: 2026-06-16, IT: 2026-06-16, ES: 2026-06-15

Condition(s): Primary Immune Complex Membranoproliferative Glomerulonephritis (IC-MPGN), C3 Glomerulopathy (C3G)
Product: ASPAVELI 1 080 mg solution for infusion, ASPAVELI 1 080 mg solution for infusion

Primary endpoint: Achieving UPCR of <1 g/g at 6 months after starting pegcetacoplan treatment.
Endpoint(s): • Participant demographics at time of starting pegcetacoplan (age, sex, race) • Clinical characteristics (including biomarkers) of renal disease prior to and at the time of starting pegcetacoplan • Prior and concomitant C3G and primary IC MPGN treatment information at the start of pegcetacoplan, Occurrence of, and time to the following outcomes: - ≥50% proteinuria reduction - <1 g/g UPCR - <0.5 g/g UPCR among participants aged 18 years or older, or <0.2 g/g UPCR among participants less than 18 years of age at start of pegcetacoplan treatment - Resolution of nephrotic syndrome in those with nephrotic syndrome prior to the start of pegcetacoplan treatment, Occurrence of, and time to the following clinical outcomes: - Sustained doubling of serum creatinine - Progression to CKD Stage 5 or ESRD - Receipt of new kidney transplant - New onset of maintenance dialysis (i.e., for at least 4 weeks) - Death from kidney failure, • Change in UPCR from the most recent diagnostic test results prior to the start of pegcetacoplan treatment, to test results at 1, 3, 6, 12 months, and then every 6 months after starting pegcetacoplan treatment • Achieving UPCR of <1 g/g at 1, 3, 6, 12 months and then every 6 months after starting pegcetacoplan treatment, • Change in eGFR derived from the most recent diagnostic test results of creatinine and height (if applicable) before the start of pegcetacoplan treatment to eGFR derived at 1, 3, 6, 12 months and then yearly after starting pegcetacoplan treatment • Proportion of participants with annualised eGFR decline ≤5 mL/min/1.73 m² yearly after starting pegcetacoplan treatment, • Change in laboratory parameters at 1, 3, 6, 12 months and then yearly after starting pegcetacoplan treatment • Change in kidney biopsy findings after starting pegcetacoplan treatment • Change in each biomarker, that is assessed longitudinally, from start of pegcetacoplan at 1, 3, 6, 12 months and then yearly, • Summary of pegcetacoplan treatment information (reason for use, start/stop dates, dose regimen, dates and reasons for dose changes) • Changes in UPCR, eGFR, and C3c staining on kidney biopsy, over time including after pegcetacoplan discontinuation, pegcetacoplan restart, or switch to another complement inhibitor (e.g., iptacopan), compared to the most recent measurement before the change in anti-complement therapy, For participants who switched from pegcetacoplan to iptacopan or other complement inhibitor and vice versa, or for participants who discontinued or restarted pegcetacoplan : Change in each biomarker, that is assessed longitudinally, from the treatment change, at 2 weeks, 1, 3, 6, 12 months and every 6 months, • Exposure-adjusted incidence rate of SAEs during pegcetacoplan treatment • Exposure-adjusted incidence rate of AESIs during pegcetacoplan treatment - Severe or serious infections - Malignancies - Acute kidney injury (AKI) Stage 1–3 (KDIGO classification), • Summary scores of FACIT‑Fatigue and WPAI at the start of pegcetacoplan treatment (as available), at study enrolment, and every 6 months during treatment (by caregivers for minors) • Summary of TSQM among adult participants at the start of pegcetacoplan treatment (as available), at study enrolment, and every 6 months during treatment, • Annualised C3G and primary IC‑MPGN‑related length of hospital stays and ICU stay before, during, and after pegcetacoplan treatment • Annualised number of C3G and primary IC‑MPGN‑related inpatient or outpatient hospital visits, ICU admissions, emergency department visits before, during, and after pegcetacoplan treatment

Source: https://euclinicaltrials.eu/ctis-public/view/2025-524487-37-00